EU clinical trial 2024-519132-17-00: GEMOXIA02: HEPATIC ARTERIAL INFUSION OF GEMCITABINE-OXALIPLATIN FOR SECOND-LINE THERAPY IN NON-METASTATIC UNRESECTABLE INTRA-HEPATIC CHOLANGIOCARCINOMA: A MULTICENTRIC SINGLE-ARM PHASE II STUDY
Sponsor: Centre Hospitalier Universitaire De Montpellier (Hospital/Clinic/Other health care facility). Phase: Therapeutic exploratory (Phase II). Countries: France (authorised, recruiting).
Therapeutic area(s): Diseases [C] - Neoplasms [C04]
Gender: Female, Male. Age: 18-64 years, 65+ years. Enrolment: 40.
Status: Authorised, recruiting. Start date (EU): 2025-01-29. Decision date: 2025-01-29. Results received: No. Last updated: 2025-12-19.

Condition(s): NON-METASTATIC UNRESECTABLE INTRA-HEPATIC CHOLANGIOCARCINOMA
Product: GEMCITABINE, OXALIPLATIN

Primary endpoint: The primary endpoint is the percentage of patients with an objective response (defined as partial or complete response) 4 months after inclusion (using RECIST v1.1 criteria)
Endpoint(s): Safety :NCI-CTCAE, Quality of life (QLQ-C30 questionnaire). The time to a final deterioration in the global health score (decrease of 5 points or more with no further improvement before death). The delay will be calculated from date of the first cycle to QoL evaluation or date of death or date of last news if the patient has no deterioration, Secondary resectability rate (as evaluated by an experienced hepatic surgeon), Overall survival (estimated by the time between the date of inclusion and the date of death or date of last news for alive patients), Progression-free survival by CT-scan/MRI according to the investigator's opinion (defined as the time between the date of inclusion and the date of first progression or death [whichever occurs first] or date of last news for patients alive without any progression)

Source: https://euclinicaltrials.eu/ctis-public/view/2024-519132-17-00